EU clinical trial 2023-508736-62-00: A Phase 2, Randomized, Double-Blind, Placebo-Controlled, Dose Finding Study to Assess the Safety and Effectiveness of Tovinontrine in Patients With Chronic Heart Failure With Reduced Ejection Fraction
Protocol code: CRD-750-201
Sponsor: Cardurion Pharmaceuticals Inc. (Pharmaceutical company). Phase: Therapeutic exploratory (Phase II). Countries: Italy (ended), Czechia (ended), Germany (ended), Netherlands (ended), Hungary (ended), Belgium (ended), Spain (ended), Bulgaria (ended), Poland (ended), Latvia (ended), Slovakia (ended), Lithuania (ended).
Therapeutic area(s): Diseases [C] - Cardiovascular Diseases [C14]
Gender: Female, Male. Age: 18-64 years, 65+ years. Enrolment: 265.
Status: Ended. Start date (EU): 2024-08-08. End date (EU): 2025-10-10. End date: 2025-10-11. Decision date: 2024-05-14. Results received: No. Last updated: 2025-06-11.
Decision dates by country: NL: 2024-05-14, SK: 2025-03-18, DE: 2024-05-14, HU: 2024-05-14, ES: 2024-05-20, IT: 2024-05-17, LV: 2025-03-28, BG: 2024-05-20, PL: 2024-05-20, CZ: 2024-05-15, BE: 2024-05-15, LT: 2025-04-11

Condition(s): Heart failure (HF) with reduced ejection fraction (HFrEF)
Product: Tovinontrine, Tovinontrine, Tovinontrine, tovinontrine-matching placebo, immediate-release tablet

Primary endpoint: The percent change from baseline (pre-dose on Day 1) in plasma NT-proBNP for Doses 2 and 3 at Week 12
Endpoint(s): The percent change from baseline (pre-dose on Day 1) in urine and plasma cGMP at Week 12, The percent change from baseline (pre-dose on Day 1) in BNP at Week 12, The percent change from baseline (pre-dose on Day 1) in urine and plasma cGMP to NT-proBNP ratio at Week 12, The percent change from baseline (pre-dose on Day 1) in urine and plasma cGMP to BNP ratio at Week 12, The change from baseline (pre-dose on Day 1) in the KCCQ-23-CSS at Week 12 and the post-baseline NYHA classification at Week 12, The percent change from baseline (pre-dose on Day 1) in plasma NT proBNP at Week 12 for Dose 1

Source: https://euclinicaltrials.eu/ctis-public/view/2023-508736-62-00